EU clinical trial 2023-506936-34-00: Contribution of Contrast-Enhanced Ultrasound (CES) in the fetal-placental circulation study: EVUPACUS
Protocol code: 2021PI062
Sponsor: CHRU De Nancy (Hospital/Clinic/Other health care facility). Phase: Therapeutic confirmatory (Phase III). Countries: France (ongoing, recruiting).
Therapeutic area(s): Diseases [C] - Female Urogenital Diseases and Pregnancy Complications [C13]; Analytical, Diagnostic and Therapeutic Techniques and Equipment [E] - Diagnosis [E01]
Gender: Female. Age: 18-64 years. Enrolment: 30.
Status: Ongoing, recruiting. Start date (EU): 2025-04-09. Decision date: 2024-05-17. Results received: No. Last updated: 2024-05-17.

Condition(s): Fetal growth restriction
Product: SonoVue 8 microlitres/mL powder and solvent for dispersion for injection

Primary endpoint: Comparison of placental contrast ultrasound parameters according to the group defined by fetal weight in percentile as a function of term. Severe IntraUterine Growth Restriction (IUGR) is defined as a weight below the 3rd percentile for gestational age.
Endpoint(s): Objectives 1 and 2: Measurement of the perfusion kinetics of the contrast agent in ECUS on the foetal side (parameters of the semi-quantitative analysis obtained using VueBox software) for all patients, if applicable. In case no contrast medium passes through the cord, perfusion kinetics will not be measured., Objective 3: Association between ECUS vascularisation parameters and placental histology data (macro- and microscopic indices based on Amsterdam Standardised Analysis Criteria): placental weight, cord length, presence of macroscopic lesions (infarction, thrombosis, fibrin, calcification, haematoma), presence of histological lesions of maternal placental with bad perfusion (distal villous hypoplasia, infarction, decidual vasculopathy)., Objective 4: Obtaining placental samples to study the deposition of sulphur hexafluoride in the placenta using electronic microscopy.

Source: https://euclinicaltrials.eu/ctis-public/view/2023-506936-34-00